EU clinical trial 2025-522362-78-00: A Study to Evaluate Mirikizumab Concentrations in Breast Milk Following Administration of Mirikizumab by Subcutaneous Injection in Lactating Participants Receiving Mirikizumab Therapeutically for an Approved Indication
Protocol code: I6T-MC-AMCA
Sponsor: Eli Lilly & Co. (Pharmaceutical company). Phase: Therapeutic use (Phase IV). Countries: Spain (ended), Denmark (authorised, recruitment pending), Germany (authorised, recruiting), Italy (authorised, recruiting), Poland (authorised, recruiting).
Therapeutic area(s): Diseases [C] - Immune System Diseases [C20]
Gender: Female. Age: 0-17 years, 18-64 years, 65+ years. Enrolment: 16.
Start date (EU): 2026-06-08. Decision date: 2026-04-27. Results received: No. Last updated: 2026-07-15.
Decision dates by country: ES: 2026-04-30, PL: 2026-05-20, DE: 2026-04-27, IT: 2026-04-28, DK: 2026-04-27

Condition(s): severely active ulcerative colitis (US) and CD (Crohn’s disease)
Product: Omvoh 100 mg solution for injection in pre-filled syringe, Omvoh 100 mg + 200 mg solution for injection in pre-filled pen, Omvoh 100 mg + 200 mg solution for injection in pre-filled syringe, Omvoh 100 mg solution for injection in pre-filled pen, Omvoh 100 mg solution for injection in pre-filled syringe, Omvoh 100 mg solution for injection in pre-filled pen, Omvoh 100 mg + 200 mg solution for injection in pre-filled syringe, Omvoh 100 mg + 200 mg solution for injection in pre-filled pen, Omvoh 100 mg solution for injection in pre-filled pen

Primary endpoint: Concentration of mirikizumab in breast milk predose on Day 0, as well as each day that breast milk collection is indicated in the SoA (Section 1.3).
Endpoint(s): AUC(0-τ), Cavg, Ctrough, Cmax, and tmax, Infant weight and caregiver- or HCP-reported adverse events.

Source: https://euclinicaltrials.eu/ctis-public/view/2025-522362-78-00